EU clinical trial 2023-508544-22-00: Proof-of-principle study of inhaled pulmonary surfactant in patients with Idiopathic Pulmonary Fibrosis (INSURF-IPF)
Protocol code: KKS-310
Sponsor: Philipps-Universitaet Marburg (Educational Institution). Phase: Therapeutic exploratory (Phase II). Countries: Germany (authorised, recruitment pending).
Therapeutic area(s): Diseases [C] - Respiratory Tract Diseases [C08]
Gender: Female, Male. Age: 18-64 years, 65+ years. Enrolment: 20.
Status: Authorised, recruitment pending. Decision date: 2024-07-05. Results received: No. Last updated: 2026-08-04.

Condition(s): Idiopathic pulmonary fibrosis
Product: reconstitution solution identical to the solution provided in the alveofact box as authorized (saline solution 0,45% NaCl with 0,01% NaHCO3), ALVEOFACT® 45 mg/ml 54 mg, Pulver und Lösungsmittel zur Herstellung einer Suspension

Primary endpoint: The primary endpoint is the mean intra-individual difference in the percentage change in FVC from baseline to the end of each inhalation phase
Endpoint(s): Change in Total Lung Capacity (TLC) from baseline to the end of each inhalation phase, Change in Forced Expiratory Volume in one second (FEV1) from baseline to the end of each inhalation phase, Change in FEV1/FVC ratio, Change in parameters R5, R20, X5, RF and AX from oscillometry (IOS) from baseline to the end of each inhalation phase, Change in diffusion capacity for CO (TLCO), KCO from baseline to the end of each inhalation phase, Change in arterial partial pressure of O2 (paO2) from baseline to the end of each inhalation phase, Change in O2 saturation (SpO2) between rest and exercise (at the end of the 6MWT) from baseline to the end of each inhalation phase, Change in 6-minute walking distance (6MWT) from baseline to the end of each inhalation phase, Change in intratidal gas volume (ITV) from baseline to the end of each inhalation phase, Change in tidal impedance distribution (TID) from baseline to the end of each inhalation phase, Change in difference of TID over time (dTID) from baseline to the end of each inhalation phase, Change in surface of ventilated areas (SURF) from baseline to the end of each inhalation phase, Change in global inhomogeneity index (GI) from baseline to the end of each inhalation phase, Change in end-expiratory lung impedance (EELI) from baseline to the end of each inhalation phase, Change in difference of EELI over time (dEELI) from baseline to the end of each inhalation phase, Assessment of toxicity and safety during the course of the study: AEs, SAEs, Patient related outcome measures (PROMS): questionnaires KBILD, Leicester Cough and EQ-5D-5L from baseline to the end of each inhalation phase

Source: https://euclinicaltrials.eu/ctis-public/view/2023-508544-22-00